EU clinical trial 2025-523410-84-00: An open label, balanced, randomized, two-treatment, two-period, two-sequence, single dose crossover, bioavailability study comparing Bupropion Hydrochloride Extended Release Capsules 150 mg, Manufactured by Sun Pharmaceutical Industries Limited, India with WELLBUTRIN XL (Bupropion hydrochloride) extended release tablets 300 mg, Distributed by: Bausch Health US, LLC Bridgewater, NJ 08807 USA. Manufactured by: Bausch Health Companies, Inc. Steinbach, MB R5G 1Z7, Canada, in healthy, adult, human subjects under fasting condition.
Protocol code: BUPRO-05-25
Sponsor: Sun Pharmaceutical Industries Limited (Pharmaceutical company). Phase: Human Pharmacology (Phase I)- Bioequivalence Study. Countries: Romania (authorised, recruitment pending).
Therapeutic area(s): Psychiatry and Psychology [F] - Mental Disorders [F03]
Gender: Female, Male. Age: 18-64 years. Enrolment: 72.
Status: Authorised, recruitment pending. Decision date: 2026-05-05. Results received: No. Last updated: 2026-05-05.

Condition(s): Seasonal affective disorder, Major depressive disorder

Source: https://euclinicaltrials.eu/ctis-public/view/2025-523410-84-00